EU clinical trial 2023-506675-96-00: COLchicine and Thiamine in Heart Failure due to Ischemic Heart Disease (COLT-HF)
Protocol code: PHRI.COLT-HF
Sponsor: Hamilton Health Sciences Corporation (Hospital/Clinic/Other health care facility). Phase: Therapeutic confirmatory (Phase III). Countries: Italy (ongoing, recruiting).
Therapeutic area(s): Diseases [C] - Cardiovascular Diseases [C14]
Gender: Female, Male. Age: 18-64 years, 65+ years. Enrolment: 300.
Status: Ongoing, recruiting. Start date (EU): 2025-01-23. Decision date: 2024-10-30. Results received: No. Last updated: 2026-07-13.

Condition(s): Heart Failure
Product: COLCHICINA LIRCA 0.5 mg compresse, Benerva 300 mg compresse gastroresistenti, Placebo tablet matching Colchicina

Primary endpoint: Colchicine arm: Composite of CV death, HF event, or ischemic CV event (defined as myocardial infarction, ischemic stroke, or arterial revascularization), Thiamine arm: Composite of CV death or HF event
Endpoint(s): All cause death, hospitalization, Serious adverse events, Side effects or adverse events resulting in study drug discontinuation

Source: https://euclinicaltrials.eu/ctis-public/view/2023-506675-96-00